EU clinical trial 2024-520141-23-01: Immunogenicity after a prime dose and revaccination with adjuvanted RSVPreF3 vaccine in the most elderly and frail population – an open-labeled phase IIIb-trial RSV Immunogenicity Study in the Elderly (RISE)
Protocol code: RISE
Sponsor: Karolinska Institutet (Educational Institution). Phase: Therapeutic confirmatory (Phase III). Countries: Sweden (authorised, recruitment pending).
Therapeutic area(s): Diseases [C] - Virus Diseases [C02]; Diseases [C] - Respiratory Tract Diseases [C08]
Gender: Female, Male. Age: 18-64 years, 65+ years. Enrolment: 70.
Status: Authorised, recruitment pending. Decision date: 2025-07-01. Results received: No. Last updated: 2025-07-01.

Condition(s): RSV infection
Product: RESPIRATORY SYNCYTIAL VIRUS VACCINES

Primary endpoint: To describe the neutralizing antibody titers against RSV A and B one month after the prime dose (day 31) of Arexvy in study participants 60 65 years old and ≥80 years old.
Endpoint(s): Occurrence, intensity and duration of solicited AEs in the study participants at the administration site and solicited systemic AEs with an onset during the 4-day follow-up period after each vaccination., Incidence of unsolicited AEs in the study participants with an onset during the 30 day follow-up period after each vaccination., Incidence of SAEs or pIMDs in the study participants from the day of vaccination until 6 months., Occurrence of any fatal SAEs from day 1 up to study end.

Source: https://euclinicaltrials.eu/ctis-public/view/2024-520141-23-01